EU clinical trial 2024-512224-11-00: DURVALUNG_A phase II study of durvalumab (MEDI 4736) maintenance in frail limited disease small cell lung cancer patients after thoracic chemoradiotherapy (CRT)
Protocol code: UC-IMM-2106
Sponsor: Unicancer (Hospital/Clinic/Other health care facility). Phase: Therapeutic exploratory (Phase II). Countries: France (ongoing, recruitment ended).
Therapeutic area(s): Diseases [C] - Neoplasms [C04]
Gender: Female, Male. Age: 18-64 years, 65+ years. Enrolment: 29.
Status: Ongoing, recruitment ended. Start date (EU): 2023-03-24. Decision date: 2024-04-17. Results received: No. Last updated: 2026-07-03.

Condition(s): Histologically confirmed frail Limited Disease Small Cell Lung Cancer (ECOG PS 2, ECOG PS 0-1 and older than 70 or did not receive a concomitant thoracic CRT because of comorbidities) previously untreated
Product: IMFINZI 50 mg/mL concentrate for solution for infusion.

Primary endpoint: PFS is defined by investigator as the time from inclusion until disease progression (per RECIST v1.1) or death from any cause, whichever occurs first.
Endpoint(s): Overall Survival (OS) is defined as the time from inclusion to death due to any cause. Patients still alive at the time of analysis (including lost to follow-up) will be censored at the last known alive date., Safety profile: occurrence of adverse events coded using NCI CTC-AE version 5.0., Quality of life (QL) will be assessed by the European Organization for Research and Treatment of Cancer (EORTC) core QL questionnaire, the EORTC QLQ-C30 and LC13 questionnaires (Lung Cancer Module).

Source: https://euclinicaltrials.eu/ctis-public/view/2024-512224-11-00